EU clinical trial 2025-525020-99-00: PROPHY-SEIN - Evaluation of the effect of antibiotic prophylaxis during lumpectomy for breast cancer: prospective randomised double-blind noninferiority study of placebo vs cefazolin
Protocol code: PHRC 2024 GARNIER
Sponsor: University Hospital Of Clermont-Ferrand (Hospital/Clinic/Other health care facility). Phase: Therapeutic confirmatory (Phase III). Countries: France (authorised, recruitment pending).
Therapeutic area(s): Not possible to specify
Gender: Female. Age: 18-64 years, 65+ years. Enrolment: 1600.
Status: Authorised, recruitment pending. Decision date: 2026-07-16. Results received: No. Last updated: 2026-07-16.

Condition(s): Breast Cancer
Product: CEFAZOLINE VIATRIS 2 g, poudre pour solution injectable (IM-IV), CHLORURE DE SODIUM VIAFLO 0,9 % sol p perf, Cefazoline Viatris 1 g poudre pour solution injectable ou pour perfusion, SODIUM CHLORIDE

Primary endpoint: The primary outcome will be the proportion of patients with any SSI within 30 days after breast lumpectomy/partial mastectomy.
Endpoint(s): The proportion of patients with each type of SSI (superficial or deep). SSI will be classified as being superficial or deep on the basis of validated and well-defined criteria developed by the US Centre for Disease Control and Prevention, The proportion of SSI among patients operated on for simple lumpectomy and for lumpectomy combined with a sentinel lymph node procedure., The proportion of SSI among patients with and without preoperative localisation of the tumour using a percutaneous device, such as metal wire., The proportion, type and severity (minor, moderate, severe, lethal) of intraoperative and postoperative adverse events potentially attributable to cefazolin or its placebo, and their causality according to the WHO scale (certain, probable, possible, unlikely, conditional, unassessable), The proportion, type and severity of postoperative complication, according to the Clavien and Dindo classification, The medical and/or surgical management of any SSI (need for antibiotics and duration, need for additional scare care or reopening, need for surgical revision, etc.), The duration of index hospital stay and whether the index stay had to be prolonged, notably due to the occurrence of a SSI., The need for an unexpected medical or surgical consultation or hospital readmission for a suspected or confirmed SSI, The proportion of patients with postoperative sepsis or septic shock., The need for unexpected admission to the ICU., The time to initiation of adjuvant chemotherapy and/or radiotherapy (if indicated by the attending oncologist), All-causes and septic-related mortality.

Source: https://euclinicaltrials.eu/ctis-public/view/2025-525020-99-00